EU clinical trial 2024-516450-21-00: PROSPECTIVE EVALUATION OF THE DDR GENES ALTERATION TO PREDICT RESPONSE TO PLATINUM-BASED CHEMOTHERAPY IN ADVANCED UROTHELIAL CANCER
Protocol code: SELECTIO-UC
Sponsor: Fondazione Policlinico Universitario Agostino Gemelli IRCCS (Hospital/Clinic/Other health care facility). Phase: Therapeutic use (Phase IV). Countries: Italy (ongoing, recruiting).
Therapeutic area(s): Diseases [C] - Neoplasms [C04]
Gender: Female, Male. Age: 18-64 years, 65+ years. Enrolment: 135.
Status: Ongoing, recruiting. Start date (EU): 2024-12-31. Decision date: 2024-11-20. Results received: No. Last updated: 2025-05-28.

Condition(s): metastatic or locally advanced urothelial cancer
Product: GEMCITABINE HYDROCHLORIDE, CISPLATIN, AVELUMAB, CISPLATIN, CISPLATIN, CISPLATIN, CARBOPLATIN, CARBOPLATIN, GEMCITABINE HYDROCHLORIDE

Primary endpoint: To assess the difference in ORR defined as the percentage of patients who achieve PR or CR as measured by RECIST 1.1, to the platinum-based chemotherapy between patients with metastatic or locally advanced urothelial cancer with or without DDR genes alterations. Radiological confirmation of the response is not required
Endpoint(s): To evaluate the PFS defined as the time elapsed from start of investigational treatment to the documentation of investigatorassessed disease progression, according to RECIST 1.1, or death due to any cause, whichever occurs first in patients with or without DDR genes alterations, To evaluate the OS defined as time elapsed from start of investigational treatment to the date of death due to any cause in patients with or without DDR genes alterations, To evaluate the ORR defined as the percentage of patients who achieve PR or CR as measured by RECIST 1.1 criteria in patients with or without DDR genes alterations between those treated with carboplatin o cisplatin, To evaluate the disease control rate (DCR) defined as the percentage of patients who achieve stable disease (SD) or PR or CR as measured by RECIST 1.1 criteria in patients with or without DDR genes alterations between those treated with carboplatin o cisplatin, To evaluate the incidence of chemo-related adverse events in patients with or without DDR genes alterations graded according to NCI CTCAE version 5.0, Translational endpoint: to describe the incidence of DDR alteration found in NGS analysis performed among the eligible patients, Traslational endpoint: To describe the expression of Nectin4, PDL1, Trop2 and Her2 proteins in tumor tissue

Source: https://euclinicaltrials.eu/ctis-public/view/2024-516450-21-00